EU clinical trial 2025-520702-35-00: A randomised, open-label, 5-period, cross-over trial to assess the pharmacokinetics and safety of 3 oral solid formulations of buloxibutid (C21) in healthy male and female participants
Protocol code: VP-C21-014
Sponsor: Vicore Pharma AB (Pharmaceutical company). Phase: Human Pharmacology (Phase I)- Other. Countries: Sweden (ended).
Therapeutic area(s): Diseases [C] - Respiratory Tract Diseases [C08]
Gender: Female, Male. Age: 18-64 years. Enrolment: 30.
Status: Ended. Start date (EU): 2025-05-14. End date (EU): 2025-08-25. Decision date: 2025-04-22. Results received: No. Last updated: 2025-04-22.

Condition(s): Idiopahtic pulmonary fibrosis

Source: https://euclinicaltrials.eu/ctis-public/view/2025-520702-35-00